EU clinical trial 2024-513597-22-00: Comparison of the effectiveness of first-line preventive treatment of migraine in primary care: a pragmatic clinical trial [PREMI study]
Protocol code: IJG-PREMI-2024
Sponsor: Institut Universitari D Investigacio En Atencion Primaria Jordi Gol (Laboratory/Research/Testing facility). Phase: Therapeutic use (Phase IV). Countries: Spain (ongoing, recruiting).
Therapeutic area(s): Diseases [C] - Nervous System Diseases [C10]
Gender: Female, Male. Age: 18-64 years, 65+ years. Enrolment: 460.
Status: Ongoing, recruiting. Start date (EU): 2025-04-29. Decision date: 2024-10-03. Results received: No. Last updated: 2026-08-07.

Condition(s): Migraine
Product: AMITRIPTYLINE, TOPIRAMATE, FLUNARIZINE, PROPRANOLOL

Primary endpoint: Clinical effectiveness: change in the mean number of monthly migraine days (MMD) at 12 weeks of treatment from baseline.
Endpoint(s): Proportion of patients responding at 12 weeks from start of treatment; <25% change in mean number of MMD: non-responders, 25-49%: partial responders, 50-75%: responders, >75%: excellent responders., Change in mean number of MMDs at 4 and 8 weeks from baseline., Reduction in the mean number of moderate-severe MMD at 4, 8 and 12 weeks from the start of treatment., Proportion of patients with associated symptoms at 12 weeks from the start of treatment; photophobia, phonophobia, nausea., Proportion of adherent and non-adherent patients (according to taking [yes/no] of the study treatment with the prescribed dosage) at 12 weeks from the start of treatment., Change in the mean number of drugs used for symptomatic treatment at 4, 8 and 12 weeks from baseline., Reconsultations: Type of consultation (PCC, PC emergency, hospital, hospital emergency). Number of consultations after 12 weeks from the start. Number of medical tests performed relacionadas con la migraña., Patients' Global Impression of Change (PGIC) scale at 12 weeks., Change in EQ-5D-5L questionnaire at 12 weeks from baseline., Change in HIT-6 questionnaire at 12 weeks from baseline., Change in the number of ILT days, absenteeism, presenteeism at 12 weeks from the start of treatment., Adherence to treatment 6 months after the start of the trial., Switching or discontinuation of drug for preventive treatment after 6 months from the start of the trial.

Source: https://euclinicaltrials.eu/ctis-public/view/2024-513597-22-00